EU clinical trial 2022-500694-14-00: Phase 1-2 Study Investigating Safety, Tolerability, Pharmacokinetics and Preliminary Antitumor Activity of Various Combinations of BGB-A425 and LBL-007 with Tislelizumab in Patients with Advanced Solid Tumors
Protocol code: BGB-900-102
Sponsor: Beigene Ltd. (Pharmaceutical company). Phase: Phase I and Phase II (Integrated)- First administration to humans. Countries: France (ended), Spain (ended), Poland (ended), Italy (ended).
Therapeutic area(s): Diseases [C] - Neoplasms [C04]
Gender: Female, Male. Age: 18-64 years, 65+ years. Enrolment: 48.
Status: Ended. Start date (EU): 2023-06-02. End date (EU): 2025-02-06. End date: 2025-02-07. Decision date: 2022-10-24. Results received: Yes. Last updated: 2025-01-31.
Decision dates by country: FR: 2022-10-24, IT: 2022-10-31, PL: 2022-11-01, ES: 2022-10-31

Condition(s): Head and Neck Squamous Cell Cancer, Renal Cell Carcinoma, Non-Small Cell Lung Cancer
Product: BGB-A425, LBL-007, Tislelizumab

Primary endpoint: Phase 1(Dose Escalation) & Phase 2(Safety Lead-in): Adverse events (AEs) and serious AE (SAEs) as characterized by type, frequency, severity (as graded by National Cancer Institute-Common Terminology Criteria for Adverse Events [NCI-CTCAE] Version 5.0), timing, seriousness, and relationship to study therapy; laboratory abnormalities as characterized by type, frequency, severity (as graded by NCI CTCAE v5.0), and timing; AEs meeting protocol defined dose limiting toxicity (DLT) criteria, Phase 1 (Dose Escalation) & Phase 2 (Safety Lead-in): The MTD or MAD is defined as the highest dose at which < 33% of the patients experience a DLT, Phase 1 (Dose Escalation) & Phase 2 (Safety Lead-in): The RP2D/recommended dose for expansion of the combination treatments will be determined based upon the MTD or MAD, and will also take into consideration the longterm tolerability, PK, efficacy, and any other relevant data as available, Phase 2 (Dose Expansion): ORR as determined from investigator derived tumor assessments per RECIST v1.1
Endpoint(s): Phase 1 (Dose Escalation) & Phase 2 (Safety Lead-in): Efficacy evaluations: ORR, duration of response (DOR), and disease control rate (DCR) will be determined from investigator derived tumor assessments per RECIST v1.1, Phase 1 (Dose Escalation) & Phase 2 (Safety Lead-in): PK: Maximum observed plasma concentration (Cmax), minimum observed plasma concentration (Cmin), time to maximum plasma concentration (Tmax), half-life (t1/2), area under the concentration-time curve from zero to 21 days (AUC0-21d), CL, and apparent volume of distribution (Vz) for BGB-A425 and LBL-007; Cmax and Cmin for tislelizumab, Phase 1 (Dose Escalation) & Phase 2 (Safety Lead-in): Immunogenicity: Immunogenic responses to BGB-A425, LBL-007, and tislelizumab will be assessed by summarizing the number and percentage of patients who develop detectable antidrug antibodies, Phase 2 (Dose Expansion): Progression-free survival (PFS), DOR, and DCR will be determined from investigator derived tumor assessments as per RECIST v1.1, Phase 2 (Dose Expansion): Safety and tolerability: The safety of various combinations of BGB-A425 and LBL-007 with tislelizumab will be assessed throughout the study by monitoring AEs and SAEs per NCI-CTCAE v5.0, physical examinations, electrocardiograms (ECGs), and laboratory assessments as needed, Phase 2 (Dose Expansion): PK: PK parameters such as Cmax, Cmin, Tmax, t1/2, and AUC0-21d for BGB-A425 and LBL-007; Cmax and Cmin for tislelizumab, Phase 2 (Dose Expansion): Immunogenicity: Immunogenic responses to BGB-A425, LBL-007, and tislelizumab will be assessed by summarizing the number and percentage of patients who develop detectable antidrug antibodies (ADAs).

Source: https://euclinicaltrials.eu/ctis-public/view/2022-500694-14-00